EU clinical trial 2023-509022-22-00: Antiplatelet therapy added to standard thromboprophylaxis to prevent thrombosis in pancreatic cancer patients - a randomized clinical trial (The PANART trial)
Sponsor: Akershus University Hospital (Hospital/Clinic/Other health care facility). Phase: Therapeutic confirmatory (Phase III). Countries: Norway (ongoing, recruiting).
Therapeutic area(s): Diseases [C] - Neoplasms [C04]; Diseases [C] - Cardiovascular Diseases [C14]
Gender: Female, Male. Age: 18-64 years, 65+ years. Enrolment: 744.
Status: Ongoing, recruiting. Start date (EU): 2025-08-21. Decision date: 2024-08-26. Results received: No. Last updated: 2026-05-13.

Condition(s): Pancreatic ductal cancer
Product: Fragmin 5 000 IE injeksjonsvæske, oppløsning i ferdigfylt sprøyte, Plavix 75 mg film-coated tablets

Primary endpoint: Efficacy: A composite of objectively verified arterial or venous thrombosis. Safety: Major bleeding.
Endpoint(s): Death

Source: https://euclinicaltrials.eu/ctis-public/view/2023-509022-22-00